EU clinical trial 2024-514561-20-00: A Phase I study to evaluate the pharmacokinetics, safety and tolerability of multiple oral doses of obefazimod in participants with renal impairment and matched normal kidney function.
Protocol code: ABX464-907
Sponsor: Abivax (Pharmaceutical company). Phase: Human Pharmacology (Phase I)- Other. Countries: Germany (ended).
Therapeutic area(s): Diseases [C] - Digestive System Diseases [C06]
Gender: Female, Male. Age: 18-64 years, 65+ years. Enrolment: 48.
Status: Ended. Start date (EU): 2024-09-09. End date (EU): 2025-10-14. Decision date: 2024-08-15. Results received: No. Last updated: 2025-03-10.

Condition(s): Moderately to severely active ulcerative colitis

Source: https://euclinicaltrials.eu/ctis-public/view/2024-514561-20-00